EU clinical trial 2023-510240-20-00: Combination of Ponatinib Plus Chemotherapy As Frontline Treatment For Patients With BCR/ABL1-Like Acute Lymphoblastic Leukemia (BCR/ABL1-Like ALL) - BALLik. ALL2922
Protocol code: GIMEMA ALL2922
Sponsor: Fondazione Gimema Franco Mandelli Onlus (Health care). Phase: Therapeutic exploratory (Phase II). Countries: Italy (ongoing, recruiting).
Therapeutic area(s): Diseases [C] - Hemic and Lymphatic Diseases [C15]
Gender: Female, Male. Age: 18-64 years. Enrolment: 32.
Status: Ongoing, recruiting. Start date (EU): 2022-10-05. Decision date: 2024-07-16. Results received: No. Last updated: 2026-07-24.

Condition(s): Adult Philadelphia Chromosome-Negative Acute Lymphoblastic Leukemia.
Product: Iclusig 15 mg film-coated tablets, CYTARABINE, CYCLOPHOSPHAMIDE, LENOGRASTIM, VINCRISTINE SULFATE, IDARUBICIN HYDROCHLORIDE, PREDNISONE, METHOTREXATE, METHOTREXATE, METHYLPREDNISOLONE SODIUM SUCCINATE, FOLINIC ACID, MERCAPTOPURINE, Iclusig 15 mg film-coated tablets, DEXAMETHASONE DISODIUM PHOSPHATE, CYTARABINE, FILGRASTIM

Primary endpoint: The primary endpoint of this study is to evaluate clinical response - in terms of MRD negativity rate after 3 cycles (TP2) in patients with BCR/ABL1-like ALL treated with a Ponatinib plus chemotherapy approach.
Endpoint(s): The rate of MRD negativity at 2 timepoints TP1, TP3, DFS at 24 months, EFS at 24 months, CIR estimation from CR achievement at 24 months, OS at 24 months, Treatment-related mortality (TRM), Rate of patients in CR after TP2, Rate of patients who undego transplantion and who complete the Chemotherapy plus ponatinib scheme, Rate of Adverse Events (AEs) and Seriuos AEs related to Ponatinib

Source: https://euclinicaltrials.eu/ctis-public/view/2023-510240-20-00